EU clinical trial 2023-505251-43-00: A Phase III Randomised, Parallel-Group, Double-Blind, Placebo-Controlled, Two-Arm Study to Evaluate the Efficacy and Safety of Elafibranor 80 mg on Long-Term Clinical Outcomes in Adult Participants With Primary Biliary Cholangitis (PBC)
Protocol code: CLIN-60190-454
Sponsor: Ipsen Bioscience Inc. (Industry). Phase: Therapeutic confirmatory (Phase III). Countries: Belgium (ongoing, recruiting), Italy (ongoing, recruiting), Romania (ongoing, recruiting), Spain (ongoing, recruiting), Czechia (ongoing, recruiting), France (ongoing, recruiting), Poland (ongoing, recruiting), Bulgaria (ongoing, recruiting), Denmark (ongoing, recruiting), Greece (ongoing, recruiting), Hungary (authorised, recruiting), Portugal (authorised, recruitment pending), Slovakia (authorised, recruiting), Lithuania (authorised, recruitment pending).
Therapeutic area(s): Diseases [C] - Digestive System Diseases [C06]
Gender: Female, Male. Age: 18-64 years, 65+ years. Enrolment: 132.
Start date (EU): 2024-02-28. Decision date: 2024-02-05. Results received: No. Last updated: 2026-03-24.
Decision dates by country: CZ: 2024-05-30, ES: 2024-05-27, BE: 2024-02-07, FR: 2024-05-28, PL: 2024-05-31, IT: 2024-02-06, HU: 2025-02-27, RO: 2024-02-12, LT: 2025-10-06, GR: 2025-02-25, DK: 2025-03-03, SK: 2025-10-20, BG: 2025-02-27, PT: 2025-09-22

Condition(s): Primary Biliary Cholangitis
Product: elafibranor, Placebo tablet

Primary endpoint: Event-free survival. Event-free survival is defined as the time from randomization to either adjudicated disease progression or death, whichever occurs first. [Time Frame: From baseline until 4 weeks after the end of treatment (maximum duration of 3.5 years)]
Endpoint(s): Percentage of participants experiencing Treatment Emergent Adverse Events (TEAEs), treatment-related TEAEs, Serious Adverse Events (SAEs), and Adverse Events of Special Interests (AESIs). [Time Frame: From baseline until 4 weeks after the end of treatment (maximum duration of 3.5 years)], Percentage of participants developing clinically significant changes in physical examination findings Complete physical examination at screening and targeted examination at all other clinical visit timepoints. [Time Frame: From baseline until 4 weeks after the end of treatment (maximum duration of 3.5 years)], Percentage of participants developing clinically significant changes in vital signs Percentage of participants with clinically significant changes in Vital Signs will be reported. The clinical significance will be graded by the investigator. [Time Frame: From baseline until 4 weeks after the end of treatment (maximum duration of 3.5 years)], Percentage of participants developing clinically significant changes in Electrocardiogram (ECG) readings. Percentage of participants with clinically significant changes in ECG readings will be reported. The clinical significance will be graded by the investigator. [Time Frame: From baseline until 4 weeks after the end of treatment (maximum duration of 3.5 years)], Percentage of participants with clinically significant changes in laboratory parameters (blood chemistry, haematology, coagulation and urinalysis) Percentage of participants with clinically significant change in laboratory parameters (blood chemistry, haematology and coagulation) will be reported. The clinical significance will be graded by the investigator. [Time Frame: From baseline until 4 weeks after the end of treatment (maximum duration of 3.5 years)], Change from baseline in Alkaline phosphatase (ALP) [Time Frame: At Month 6, Month 12, and every 12 months up to end of treatment (maximum duration of 3.5 years)], Change from baseline in Total Bilirubin (TB) [Time Frame: At Month 6, Month 12, and every 12 months up to end of treatment (maximum duration of 3.5 years)], Percentage of participants with ALP≤ 1.67x ULN and TB≤ ULN [Time Frame: At Month 6, Month 12, and every 12 months up to end of treatment (maximum duration of 3.5 years)], Percentage of participants with complete biochemical response Defined as normal levels of TB, ALP, transaminases, albumin, and International normalised ratio (INR) [Time Frame: At Month 6, Month 12, and every 12 months up to end of treatment (maximum duration of 3.5 years)], Percentage of participants with normalisation of TB and ALP Defined as TB< Upper Limit Normal (ULN) and ALP< ULN [Time Frame: At Month 6, Month 12, and every 12 months up to end of treatment (maximum duration of 3.5 years)], Percentage of participants with stabilisation in TB (i.e. no increase) Defined as TB< 1x ULN or increase from baseline <0.1x ULN [Time Frame: At Month 6, Month 12, and every 12 months up to end of treatment (maximum duration of 3.5 years)], Percentage of participants with a response based on albumin normalisation [Time Frame: At Month 6, Month 12, and every 12 months up to end of treatment (maximum duration of 3.5 years)], Change from baseline in liver stiffness measurement (LSM) Assessed by vibration-controlled transient elastography (VCTE) using Fibroscan® on the day of the visit. [Time Frame: At Month 12, and every 12 months up to end of treatment (maximum duration of 3.5 years)], Change from baseline in PBC risk scores based in GLOBE score. GLOBE scoring system, which calculation is based on serum values of bilirubin, ALP, albumin and platelet count after 1 year of treatment and age at baseline. A high number is indicative of a worse score. [Time Frame: At Month 12, and every 12 months up to end of treatment (maximum duration of 3.5 years)], Change from baseline in UK-PBC score based on laboratory test measurements and upper limits of normal (ULN) for total BIL12; TA12 and ALP12 after at least 12 months of UDCA, and the laboratory test measurements and lower limits of normal (LLN) for the serum albumin and platelet count in the same timeframe. [Time Frame: At Month 12, and every 12 months up to end of treatment (maximum duration of 3.5 years)], Percentage of participants with LSM ≥15 kPa Assessed by VCTE using Fibroscan® [Time Frame: At Month 12, and every 12 months up to end of treatment (maximum duration of 3.5 years)], Change from baseline in hepatic function: Aspartate aminotransferase (AST) [Time Frame: At Month 12, and every 12 months up to end of treatment (maximum duration of 3.5 years)], Change from baseline in hepatic function: ALT [Time Frame: At Month 12, and every 12 months up to end of treatment (maximum duration of 3.5 years)], Change from baseline in hepatic function: Gamma-glutamyl transferase (GGT) [Time Frame: At Month 12, and every 12 months up to end of treatment (maximum duration of 3.5 years)], Change from baseline in hepatic function: Conjugated bilirubin [Time Frame: At Month 12, and every 12 months up to end of treatment (maximum duration of 3.5 years)], Change from baseline in hepatic function: Albumin [Time Frame: At Month 12, and every 12 months up to end of treatment (maximum duration of 3.5 years)], Change from baseline in hepatic function: international normalised ratio (INR) [Time Frame: At Month 12, and every 12 months up to end of treatment (maximum duration of 3.5 years)], Change from baseline in hepatic function: fractionated ALP [Time Frame: At Month 12, and every 12 months up to end of treatment (maximum duration of 3.5 years)], Percentage of participants with no worsening of LSM Assessed by VCTE using Fibroscan® defined as no increase >2kPa from baseline [Time Frame: At Month 12, and every 12 months up to end of treatment (maximum duration of 3.5 years)], Percentage of participants with ALP reduction of 40% [Time Frame: At Month 6, Month 12, and every 12 months up to end of treatment (maximum duration of 3.5 years)], Percentage of participants with ALP <1.5x ULN, ALP decrease ≥15% and TB ≤ULN [Time Frame: At Month 6, Month 12, and every 12 months up to end of treatment (maximum duration of 3.5 years)], Percentage of participants with ALP <1.5x ULN, ALP decrease ≥40% and TB ≤ULN [Time Frame: At Month 6, Month 12, and every 12 months up to end of treatment (maximum duration of 3.5 years)], Percentage of participants with ALP <1.67x ULN, ALP decrease ≥15% and TB ≤ULN [Time Frame: At Month 6, Month 12, and every 12 months up to end of treatment (maximum duration of 3.5 years)], Percentage of participants with ALP <3x ULN, AST <2x ULN and TB ≤1 mg/dL (Paris I) [Time Frame: At Month 6, Month 12, and every 12 months up to end of treatment (maximum duration of 3.5 years)], Percentage of participants with ALP ≤1.5x ULN, AST ≤1.5x ULN and TB ≤1 mg/dL (Paris II criteria) [Time Frame: At Month 6, Month 12, and every 12 months up to end of treatment (maximum duration of 3.5 years)], Percentage of participants with normalisation of abnormal TB [Time Frame: Assessed at Month 6, Month 12, and every 12 months up to end of treatment (maximum duration of 3.5 years)], Percentage of participants with normalisation of abnormal TB and albumin (Rotterdam criteria) [Time Frame: At Month 6, Month 12, and every 12 months up to end of treatment (maximum duration of 3.5 years)], Percentage of participants with reduction in TB to ≤0.6x ULN in participants with TB >0.6x ULN at baseline [Time Frame: At Month 6, Month 12, and every 12 months up to end of treatment (maximum duration of 3.5 years)], Change from baseline in lipid parameters: total cholesterol (TC) [Time Frame: At Month 6, Month 12, and every 12 months up to end of treatment (maximum duration of 3.5 years)], Change from baseline in lipid parameters: high density lipoprotein cholesterol (HDL-C) [Time Frame: At Month 6, Month 12, and every 12 months up to end of treatment (maximum duration of 3.5 years)], Change from baseline in lipid parameters: calculated very low density lipoprotein cholesterol (VLDL-C) [Time Frame: At Month 6, Month 12, and every 12 months up to end of treatment (maximum duration of 3.5 years)], Change from baseline in lipid parameters: low density lipoprotein cholesterol (LDL-C) [Time Frame: At Month 6, Month 12, and every 12 months up to end of treatment (maximum duration of 3.5 years)], Change from baseline in lipid parameters: triglycerides (TG) [Time Frame: At Month 6, Month 12, and every 12 months up to end of treatment (maximum duration of 3.5 years)], Percentage of participants with a response in PBC Worst Itch NRS score Defined as ≥2-point reduction from baseline NRS in participants with a baseline NRS ≥4. [Time Frame: Through 6 months up to end of treatment (maximum duration of 3.5 years)], Percentage of participants with a response in PBC Worst Itch NRS Defined as ≥3-point reduction from baseline NRS in participants with a baseline NRS ≥4 [Time Frame: Assessed through 6 months up to end of treatment (maximum duration of 3.5 years)], Change from baseline in 5D-Itch scale Questionnaire that assesses symptoms in terms of 5 domains: degree, duration, direction, disability and distribution. Participants rate their symptoms over the preceding 2-week period on a 1 to 5 scale, with 5 being the most affected. [Time Frame: Assessed at every 6 months up to end of treatment (maximum duration of 3.5 years)], Change from baseline in Patient Global Impression of Severity (PGI-S) A 1-item, 5-point scale designed to assess the participant’s impression of disease severity [Time Frame: Assessed at every 6 months up to end of treatment (maximum duration of 3.5 years)], Patient Global Impression of Change (PGI-C) A 1-item, 5-point scale designed to assess the participant’s impression of change in disease severity since the baseline visit [Time Frame: Assessed at every 6 months up to end of treatment (maximum duration of 3.5 years)], Change from baseline in Patient Reported Outcome Measurement Information System (PROMIS) Fatigue Short Form 7a Consists of 7 items that measure both the experience of fatigue and the interference of fatigue on daily activities over the past week. [Time Frame: Assessed at every 6 months up to end of treatment (maximum duration of 3.5 years)], Change from baseline in the Epworth Sleepiness Scale (ESS). Self-administered questionnaire that consists of 8 questions asking to rate how likely it is to fall asleep in different situations commonly encountered in daily life (each question can be scored from 0 to 3 points; ‘0’ indicates no sleepiness, ‘3’ indicates significant sleepiness). Assessed at every 6 months up to end of treatment (maximum duration of 3.5 years), Change from baseline in PBC-40 score. 40-item questionnaire that assesses symptoms across 6 domains: fatigue, emotional and social, cognitive function, general symptoms and itch. Participants respond 0 to 5 with 5 being the most affected. The PBC-40 has a 4-week recall period. Assessed at every 6 months up to end of treatment (maximum duration of 3.5 years), Change from baseline in PBC Worst Itch Numeric Rating Scale (NRS) score. Assessed at every 6 months up to end of treatment (maximum duration of 3.5 years), Change from baseline in EuroQol 5-dimensional 5-level questionnaire (EQ-5D-5L) Self-administered standardised questionnaire that assesses the 5-dimensions of mobility, self-care, usual activities, pain/discomfort, anxiety/depression descriptively (each dimension has 5 levels) and the overall health state via an EQ Visual Analogue Scale (VAS). [Time Frame: Assessed at every 6 months up to end of treatment (maximum duration of 3.5 years), Change from baseline in Work Productivity and Activity Impairment General Health (WPAI-GH) Questionnaire (6 questions) that measures absenteeism, presenteeism as well as the impairments in unpaid activity because of health problem during the past seven days. Assessed at every 6 months up to end of treatment (maximum duration of 3.5 years), Time to the first occurrence of each of individual adjudicated clinical outcome events. Among: • All-cause mortality •Liver-related mortality •Liver transplant •MELD-3.0 score ≥ 15 in participants with baseline MELD score ≤ 12 • Liver decompensation[Time Frame: From baseline until 4 weeks after the end of treatment], Area under the plasma concentration-time curve from time 0 to 24 hours: AUC0-24 [Time Frame: At Day 1/Baseline, Month 6 and Month 12 (during a dosing period of 24 hours)], Maximum (peak) plasma drug concentration: Cmax [Time Frame: At Day 1/Baseline, Month 6 and Month 12 (during a dosing period of 24 hours)], Time to reach maximum (peak) plasma concentration following drug administration): Tmax [Time Frame: At Day 1/Baseline, Month 6 and Month 12 (during a dosing period of 24 hours)], Apparent clearance of drug from plasma (CL) [Time Frame: At Day 1/Baseline, Month 6 and Month 12 (during a dosing period of 24 hours)], Apparent volume of distribution (VZ) [Time Frame: At Day 1/Baseline, Month 6 and Month 12 (during a dosing period of 24 hours)], Change from baseline in model for end-stage liver disease (MELD) 3.0 score. The MELD 3.0 score is calculated from parameters (sex, creatinine, bilirubin, INR, sodium and albumin) where a high score indicates a greater risk of needing a liver transplant. [Time Frame: From screening until end of treatment (maximum duration of 3.5 years)], Change from baseline in Child Pugh grade Child Pugh grade is calculated using bilirubin, albumin, INR, ascites and encephalopathy. A high grade is indicative of worse liver disease. [Time Frame: From screening until end of treatment (maximum duration of 3.5 years)]

Source: https://euclinicaltrials.eu/ctis-public/view/2023-505251-43-00